EU clinical trial 2024-520193-35-00: Efficacy of amoxicillin/clavulanic acid after surgical drainage of perianal abscess in the prevention of the development of anal fistula. A randomized, double-blind clinical trial.
Protocol code: PERIQxA
Sponsor: MARIANO ARTES CASELLES (Health care). Phase: Therapeutic use (Phase IV). Countries: Spain (authorised, recruitment pending).
Therapeutic area(s): Diseases [C] - Digestive System Diseases [C06]
Gender: Female, Male. Age: 18-64 years, 65+ years. Enrolment: 300.
Status: Authorised, recruitment pending. Decision date: 2025-01-14. Results received: No. Last updated: 2026-02-10.

Condition(s): Patients who underwent surgery for their first episode of a perianal abscess.
Product: Amoxicilina/Ácido clavulánico Viatris 875 mg/125 mg comprimidos recubiertos con película EFG

Primary endpoint: Percentage of patients who develop perianal fistula.
Endpoint(s): Time to onset of fistula (months)., Complexity of the fistula according to the St James´s classification., Presence of new episode of perianal abscess at follow-up., Need for scheduled surgery for perianal fistula treatment (number of interventions, time since initial event and technique used)., Quality of life questionnaire after the onset of perianal fistula (QoLAF-Q questionnaire).

Source: https://euclinicaltrials.eu/ctis-public/view/2024-520193-35-00